EU clinical trial 2024-519391-11-00: Treatment of Respiratory Complications Associated with COVID-19, Influenza A, Metapneumovirus, Respiratory Syncytial Virus (RSV) Infection Using Wharton’s Jelly (WJ)-Umbilical Cord (UC) Mesenchymal Stromal Cells (ProTrans®): open Phase IB Clinical Trial
Protocol code: Protrans V
Sponsor: NextCell Pharma AB (Pharmaceutical company). Phase: Human Pharmacology (Phase I)- Other. Countries: Sweden (authorised, recruitment pending).
Therapeutic area(s): Diseases [C] - Respiratory Tract Diseases [C08]; Diseases [C] - Virus Diseases [C02]
Gender: Female, Male. Age: 18-64 years, 65+ years. Enrolment: 9.
Status: Authorised, recruitment pending. Decision date: 2024-11-28. Results received: No. Last updated: 2025-04-04.

Condition(s): Respiratory viral disease, COVID-19, Influenza A, Metapneumovirus, Respiratory syncytial virus Infection

Source: https://euclinicaltrials.eu/ctis-public/view/2024-519391-11-00